EU clinical trial 2025-522543-18-00: A Phase 1/1b First-in-Human Study of BMS-986506 in ccRCC
Protocol code: CA242-0001
Sponsor: Bristol-Myers Squibb Services Unlimited Company (Pharmaceutical company). Phase: Human Pharmacology (Phase I)- First administration to humans. Countries: Spain (authorised, recruiting), France (ongoing, recruiting).
Therapeutic area(s): Diseases [C] - Neoplasms [C04]
Gender: Female, Male. Age: 18-64 years, 65+ years. Enrolment: 48.
Start date (EU): 2026-03-25. Decision date: 2026-02-09. Results received: No. Last updated: 2026-07-02.
Decision dates by country: FR: 2026-02-09, ES: 2026-02-16

Condition(s): Advanced Clear Cell Renal Cell Carcinoma

Source: https://euclinicaltrials.eu/ctis-public/view/2025-522543-18-00